EU clinical trial 2023-508001-25-00: “A Multicentric, Open-Label, Single Arm Phase II Study To Evaluate The Efficacy And Safety Of The Combination Of PEmbrolizumab And Lenvatinib In Pre-Treated Thymic CArcinoma PaTIents. PECATI”.
Protocol code: MedOPP341
Sponsor: Medica Scientia Innovation Research S.L. (Pharmaceutical company). Phase: Therapeutic exploratory (Phase II). Countries: Spain (ended), France (ended), Italy (ended).
Therapeutic area(s): Diseases [C] - Neoplasms [C04]
Gender: Female, Male. Age: 18-64 years, 65+ years. Enrolment: 43.
Status: Ended. Start date (EU): 2021-03-15. End date (EU): 2026-02-16. Decision date: 2024-01-08. Results received: No. Last updated: 2025-12-01.
Decision dates by country: ES: 2024-01-08, IT: 2024-01-09, FR: 2024-01-11

Condition(s): Metastatic Thymic Carcinoma & B3-thymoma.
Product: KEYTRUDA 25 mg/mL concentrate for solution for infusion, Lenvatinib, Lenvatinib

Primary endpoint: Progression free survival (PFS) rate at 5 months, defined as the percentage of patients with B3-Thymoma and TC without disease progression at 5 months after starting the treatment combination.
Endpoint(s): Response rate (RR) with the treatment combination, Maximum tumor shrinkage with the treatment combination, Disease control rate (DCR) with the treatment combination, Duration of response (DoR) with the treatment combination, Overall survival (OS), Safety and toxicity profile of the combination according to the National Cancer Institute Common Terminology Criteria for Adverse Events Version 5.0 (CTCAE v.5.0).

Source: https://euclinicaltrials.eu/ctis-public/view/2023-508001-25-00